EU clinical trial 2025-524765-24-00: A multicentre, open-label trial in healthy volunteers to assess the boostability of three different rabies pre-exposure prophylaxis regimens when administering a single-dose, intramuscular vaccination as simulated post-exposure prophylaxis at least five years following priming. "BAZOOKA_221"
Protocol code: BAZOOKA_221
Sponsor: Institute Of Tropical Medicine (Hospital/Clinic/Other health care facility). Phase: Therapeutic confirmatory (Phase III). Countries: Belgium (authorised, recruitment pending).
Therapeutic area(s): Diseases [C] - Virus Diseases [C02]
Gender: Female, Male. Age: 18-64 years. Enrolment: 561.
Status: Authorised, recruitment pending. Decision date: 2026-05-19. Results received: No. Last updated: 2026-05-19.

Condition(s): Rabies infection/prophylaxis
Product: Rabipur Pulver und Lösungsmittel zur Herstellung einer Injektionslösung in Fertigspritze Tollwutvirus (inaktiviert, Stamm Flury LEP)

Primary endpoint: Proportion of participants that have an adequate immune response (Rapid Fluorescent Focus Inhibition Test (RFFIT) levels ≥ 0.5 IU/mL, WHO standard) on Day 7 after the booster.
Endpoint(s): Proportion of participants with RFFIT levels ≥ 0.5 IU/mL on Day 14 after the booster., Proportion of participants with RFFIT levels ≥ 0.5 IU/mL on the day of the booster (Day 0)., Proportion of participants with RFFIT levels ≥ 3.0 IU/mL on Day 7 after the booster, Proportion of participants with RFFIT levels ≥ 3.0 IU/mL on Day 14 after the booster., Proportion of participants with RFFIT levels ≥ 10 IU/mL on Day 7 after the booster, Proportion of participants with RFFIT levels ≥ 10 IU/mL on Day 14 after the booster, geometric mean titers (GMTs) at all visits for all arms and the ratio with baseline GMTs per arm, Proportion of participants with swelling, pain, redness, headache, fever, or fatigue per arm., Proportion of participants with unsolicited (i.e., other) Adverse events per arm. Proportion of participants with unsolicited local reactions per arm., Proportion of participants with SAEs per arm throughout the study period after sPEP vaccination session. (EOT)

Source: https://euclinicaltrials.eu/ctis-public/view/2025-524765-24-00